EU clinical trial 2025-524133-33-00: A Randomized, Single-Blind, Fixed-Order Crossover Study to Assess the Effects of CSX-1004 Injection on Fentanyl-Induced Respiratory Depression in Healthy Adult Subjects and Subjects with Opioid Use Disorder
Protocol code: CSX-1004.201
Sponsor: Cessation Therapeutics Inc. (Pharmaceutical company). Phase: Therapeutic exploratory (Phase II). Countries: Netherlands (ongoing, recruiting).
Therapeutic area(s): Analytical, Diagnostic and Therapeutic Techniques and Equipment [E] - Anesthesia and Analgesia [E03]
Gender: Female, Male. Age: 18-64 years. Enrolment: 24.
Status: Ongoing, recruiting. Start date (EU): 2026-03-27. Decision date: 2026-03-20. Results received: No. Last updated: 2026-03-20.

Condition(s): Opioid use disorder
Product: CSX-1004, Natriumchloride 0,9%, oplossing voor infusie

Primary endpoint: Peak change in MV (absolute and % [L/min]), calculated based on a 1-minute average of the ventilation data of each individual participant.
Endpoint(s): Peak change in respiratory rate [breaths/min], oxygen saturation (SpO2), tidal volume [L], Incidence of apnea (≥20 sec loss of respiratory activity), Incidence of oxygen desaturation (<92%), Pupillometry (maximum pupil diameter), Alertness/Drowsiness visual analog scale (VAS) (minimum effect [Emin]), Any Drug Effects VAS (maximum effect [Emax]), Drug Liking VAS (Emax), High VAS (Emax)

Source: https://euclinicaltrials.eu/ctis-public/view/2025-524133-33-00